EU clinical trial 2022-502799-22-00: A multicentre randomized, double-blind, placebo-controlled, dose-finding, Phase 2 study (MARS-17) of GSK3858279 in adult participants with moderate to severe pain due to knee osteoarthritis.
Protocol code: 209978
Sponsor: Glaxosmithkline Research & Development Limited (Pharmaceutical company). Phase: Therapeutic exploratory (Phase II). Countries: Germany (ended), France (ended), Spain (ended).
Therapeutic area(s): Diseases [C] - Musculoskeletal Diseases [C05]
Gender: Female, Male. Age: 18-64 years, 65+ years. Enrolment: 80.
Status: Ended. Start date (EU): 2023-11-29. End date (EU): 2024-08-05. End date: 2024-12-03. Decision date: 2023-07-13. Results received: Yes. Last updated: 2024-06-26.
Decision dates by country: DE: 2023-07-18, ES: 2023-07-13, FR: 2023-07-19

Condition(s): Knee osteoarthritis pain
Product: Sterile 0.9% (w/v) Sodium Chloride

Primary endpoint: Change from baseline at Week 12 in weekly average of average daily pain intensity, assessed on the Numeric Rating Scale (NRS)

Source: https://euclinicaltrials.eu/ctis-public/view/2022-502799-22-00